EU clinical trial 2024-516713-21-00: Efficacy and safety of memantine as antimanic and mood-stabilizing medication for adolescents with Bipolar Disorder: a monocentric, randomized, double-blind, placebo-controlled clinical trial.
Protocol code: GR-2018-12367476
Sponsor: Ospedale Pediatrico Bambino Gesu (Hospital/Clinic/Other health care facility). Phase: Therapeutic confirmatory (Phase III). Countries: Italy (ended).
Therapeutic area(s): Psychiatry and Psychology [F] - Mental Disorders [F03]
Gender: Female, Male. Age: 0-17 years. Enrolment: 68.
Status: Ended. Start date (EU): 2023-06-09. End date (EU): 2025-03-24. Decision date: 2024-11-11. Results received: Yes. Last updated: 2024-11-11.

Condition(s): Bipolar Disorder
Product: Memantine Accord 10 mg film-coated tablets, Microcrystalline cellulose PH 102, Lactose, monohydrated, Crospovidone, Colloidal anhydrous silica, Vegetal magnesium stearate, Film coating

Primary endpoint: Improvement of manic symptoms by the mean change in YMRS total score from intake to week 12
Endpoint(s): Time-to-dropout from the AAT phase (days from start of experimental treatment to the start of aripiprazole add-on treatment) in memantine vs placebo arm, Response of [hypo]manic or mixed episodes by week 12, assessed by evaluating the percentage of subjects given memantine vs placebo showing a response of manic or mixed episodes as reduction by <=50% of the total YMRS score after 12 weeks of treatment., Pct of subs completing the52-wk study andwith remission of sx measured by the combo:-Pct of pts withCGIBP improv score<=2;-Pct of pts with a reduction of>=50% at total YMRS score and CDRS-R score;-Pct of pts with aYMRS totscore<=12,aCDRS-Rtotscore<=28and aCGI-BPseverityscore<=2;-Pct of pts needing aripiprazole in add-on to the ongoing exp tx,avg duration of add-on tx and the avg dailydose needed in memantinevsplaceboarm for the52-wk, Percentage of subjects showing improvement at the 52-week study as measured by the following outcomes: a. Percentage of patients completing the 52 weeks of the study in memantine versus placebo group; b. Significant superior increased C-GAS score in memantine vs placebo group., Safety and tolerability parameters will be evaluated by recording all adverse events (AEs) and serious adverse events (SAEs)

Source: https://euclinicaltrials.eu/ctis-public/view/2024-516713-21-00